EU clinical trial 2023-503428-24-00: A Phase 2, Randomized, Open-label, Platform Study Using a Master Protocol to Evaluate Novel Immunotherapy Combinations as First-Line Treatment in Participants with Recurrent/Metastatic PD-L1 Positive Squamous Cell Carcinoma of the Head and Neck
Protocol code: 219885
Sponsor: Glaxosmithkline Research & Development Limited (Pharmaceutical company). Phase: Therapeutic exploratory (Phase II). Countries: Hungary (ongoing, recruitment ended), Romania (ongoing, recruitment ended), Greece (ongoing, recruitment ended), Italy (ongoing, recruitment ended), Poland (ongoing, recruitment ended), Finland (ongoing, recruitment ended), Germany (ongoing, recruitment ended), France (ongoing, recruitment ended), Spain (ongoing, recruitment ended), Denmark (ended), Portugal (ended), Norway (ended).
Therapeutic area(s): Diseases [C] - Neoplasms [C04]
Gender: Female, Male. Age: 18-64 years, 65+ years. Enrolment: 232.
Start date (EU): 2024-01-19. Decision date: 2023-12-11. Results received: No. Last updated: 2026-07-08.
Decision dates by country: DK: 2023-12-11, NO: 2023-12-11, GR: 2023-12-18, DE: 2023-12-15, ES: 2023-12-18, PT: 2023-12-18, HU: 2023-12-11, IT: 2023-12-13, RO: 2023-12-15, PL: 2023-12-14, FI: 2023-12-12, FR: 2023-12-15

Condition(s): Neoplasms, Head and Neck
Product: JEMPERLI 500 mg concentrate for solution for infusion

Primary endpoint: Confirmed ORR, defined as the percentage of participants achieving confirmed CR or PR per RECIST 1.1 by investigator assessment.

Source: https://euclinicaltrials.eu/ctis-public/view/2023-503428-24-00